EU clinical trial 2023-504805-35-00: A Phase 1b/2, Open-Label Trial to Assess the Safety and Preliminary Efficacy of Epcoritamab (GEN3013; DuoBody®-CD3xCD20) in Combination With Other Agents in Subjects With B-cell Non-Hodgkin Lymphoma
Protocol code: GCT3013-02
Sponsor: Genmab A/S (Pharmaceutical company). Phase: Phase I and Phase II (Integrated)- Other. Countries: Spain (ongoing, recruitment ended), Sweden (ongoing, recruitment ended), Italy (ongoing, recruitment ended), Belgium (ongoing, recruitment ended), Finland (ended), France (ended), Netherlands (ongoing, recruitment ended), Norway (ongoing, recruitment ended), Czechia (ongoing, recruitment ended), Denmark (ongoing, recruitment ended).
Therapeutic area(s): Diseases [C] - Neoplasms [C04]
Gender: Female, Male. Age: 18-64 years, 65+ years. Enrolment: 367.
Start date (EU): 2020-10-22. Decision date: 2024-01-23. Results received: No. Last updated: 2026-04-08.
Decision dates by country: FI: 2024-01-24, FR: 2024-01-29, NO: 2024-01-23, IT: 2024-01-25, NL: 2024-01-25, BE: 2024-01-31, DK: 2024-01-24, ES: 2024-01-29, CZ: 2024-01-25, SE: 2024-01-23

Condition(s): Lymphoma of B-cell origin
Product: SILTUXIMAB, PREDNISOLONE, CYCLOPHOSPHAMIDE, CARBOPLATIN, PARACETAMOL, ETOPOSIDE, VINCRISTINE, LENALIDOMIDE, DIPHENHYDRAMINE, GEMCITABINE, PREDNISONE, OXALIPLATIN, TOCILIZUMAB, Epcoritamab, Epcoritamab, DEXAMETHASONE, DOXORUBICIN, CYTARABINE, RITUXIMAB, IFOSFAMIDE, ANAKINRA, BENDAMUSTINE

Primary endpoint: Dose Escalation Phase: - Incidence of dose-limiting toxicities - Incidence and severity of adverse events (AEs) - Incidence and severity of changes in laboratory values - Incidence of dose interruptions and delays, Expansion Phase: Arms 1-6 and 8-10: - ORR determined by Lugano criteria Arm 7: - Incidence and severity of AEs - Incidence and severity of changes in laboratory values - Incidence of dose interruptions and delays
Endpoint(s): Dose Escalation Phase:- PK parameters- Pharmacodynamic markers in blood samples and within tumor (ontreatment biopsy)- Incidence of anti-drug antibodies (ADAs) to epcoritamab- ORR determined by Lugano criteria- Duration of response (DOR) determined by Lugano criteria- Time to response (TTR) determined by Lugano criteria- Progression-free survival (PFS) determined by Lugano criteria- Overall survival (OS)- TTNT- Rate and duration of minimal residual disease (MRD) negativity, Expansion Phase:-DOR determined by Lugano criteria (Arms 1-6 and 8-10)-TTR determined by Lugano criteria (Arms 1-6 and 8-10)-PFS determined by Lugano criteria (Arms 1-6 and 8-10)-CR rate (Arm 1-10 except Arm 7 subjects in CR at baseline)-OS (Arms 1-10)-TTNT (Arms 1-10)-Rate and duration of MRD negativity (Arms 1-10)-Rate of conversion from MRD positivity to MRD negativity (Arm 7)-CR rate (Arm 7 subjects in PR at baseline)-TTCR (Arms 1-10 except Arm 7 subjects in CR at baseline)-DoCR (Arms 1-10), Incidence and severity of AEs (Arms 1-6, and 8-10) -Incidence and severity of changes in laboratory values (Arms 1-6, and 8-10) -Incidence of dose interruptions and delays (Arms 1-6, and 8-10), PK parameters, Pharmacodynamic markers in blood samples and within tumor (on treatment biopsy), Incidence of ADAs to epcoritamab

Source: https://euclinicaltrials.eu/ctis-public/view/2023-504805-35-00